EU clinical trial 2024-514661-19-01: A Phase 1, First-in-Human Study of MEN2312, a KAT6 inhibitor, as Monotherapy and in Combination in Participants with Advanced Breast Cancer
Protocol code: MEN2312-01
Sponsor: Stemline Therapeutics Inc. (Pharmaceutical company). Phase: Human Pharmacology (Phase I)- First administration to humans. Countries: Spain (ongoing, recruiting).
Therapeutic area(s): Diseases [C] - Neoplasms [C04]
Gender: Female, Male. Age: 18-64 years, 65+ years. Enrolment: 56.
Status: Ongoing, recruiting. Start date (EU): 2026-02-18. Decision date: 2025-12-29. Results received: No. Last updated: 2026-07-08.

Condition(s): Advanced ER+/HER2- Breast Cancer

Source: https://euclinicaltrials.eu/ctis-public/view/2024-514661-19-01